EU clinical trial 2022-502528-29-00: A Phase 1/2 Study to Evaluate the Safety, Pharmacokinetics, and Efficacy of BLU-222 as a Single Agent and in Combination Therapy for Patients with Advanced Solid Tumors
Protocol code: BLU-222-1101
Sponsor: Blueprint Medicines Corp. (Pharmaceutical company). Phase: Phase I and Phase II (Integrated)- First administration to humans. Countries: France (ended), Italy (ended), Belgium (ended), Spain (ended).
Therapeutic area(s): Diseases [C] - Neoplasms [C04]
Gender: Female, Male. Age: 18-64 years, 65+ years. Enrolment: 50.
Status: Ended. Start date (EU): 2024-01-09. End date (EU): 2025-07-04. Decision date: 2023-10-02. Results received: Yes. Last updated: 2025-06-25.
Decision dates by country: IT: 2023-10-04, FR: 2023-10-02, ES: 2023-10-05, BE: 2023-10-03

Condition(s): HR+ Breast Cancer; CCNE1 Amplification; HER2-negative Breast Cancer; Advanced Solid Tumor; Ovarian Cancer; Endometrial Cancer; Gastric Cancer
Product: Kisqali 200 mg film-coated tablets, Carboplatin Hikma 10 mg/ml Konzentrat zur Herstellung einer Infusionslösung, BLU-222, BLU-222, Fulvestrant STADA 250 mg Injektionslösung in einer Fertigspritze

Primary endpoint: Phase 1: • MTD determination: DLT rate; • RP2D determination: DLT, PK, pharmacodynamics, and preliminary safety data. • Overall safety profile of BLU-222, as assessed by the TEAEs, changes in vital signs, ECGs, and clinical laboratory parameters, Phase 2: • Overall response rate (ORR), defined as the proportion of patients with confirmed CR or PR according to RECIST v1.1; • Overall safety profile of BLU-222, as assessed by the TEAEs, changes in vital signs, ECGs, and clinical laboratory parameters.
Endpoint(s): Phase 1: 1. ORR, defined in Section 3.1., 2. DOR, defined as the time from first documented response of either CR or PR to the date of first documented progressive disease or death due to any cause, whichever occurs first. DOR will be analyzed for patients with confirmed CR or PR., 3. DCR, defined as the proportion of patients with confirmed CR, PR, or stable disease according to RECIST v1.1, 4. CBR, defined as the proportion of patients with confirmed CR, PR, or stable disease which the stable disease has been lasting ≥ 16 weeks from first dose date according to RECIST v1.1, 5. PFS, defined as the time from the first dose of BLU-222 until the date of first documented progressive disease or death due to any cause, whichever occurs first, 6. PK parameters of BLU-222 will include, as appropriate, Cmax, Tmax, Tlast, AUC0-24 for QD and AUC0-12 for BID, Ctrough, Vz/F, t½, CL/F, and accumulation ratio, 7. Correlations between PK parameters and safety findings of interest will be evaluated., 8. Correlations between PK parameters and antitumor activity endpoints findings of interest will be evaluated., 9. PK parameters of single oral doses of BLU-222 administered with or without a high-fat meal in patients, including Cmax, Tmax, AUC0-last measurements, 10. PK parameters of single oral doses of BLU-222 administered as the 1st and 2nd generation capsules, including Cmax, Tmax, AUC0-last, 11. Profile pharmacodynamic changes in the cyclin E/CDK2 pathway biomarker expression levels of phospho-Rb and other markers, 12. CA-125 response as defined by the GCIG CA-125 response criteria, Phase 2: 1. DOR, DCR, CBR (as defined for Phase 1 above). PFS, defined as the time from the first dose of BLU-222 until the date of first documented progressive disease or death due to any cause, whichever occurs first OS, defined as the time from the first dose of BLU-222 until the date of death due to any cause, 2. CA-125 response as defined by GCIG CA-125 response criteria, 3. PK parameters of BLU-222 will include, as appropriate, Cmax, Clast, Tmax or AUC0-last, 4. Correlations between PK parameters and safety findings of interest will be evaluated., 5. Correlations between PK parameters and antitumor activity endpoints will be evaluated.

Source: https://euclinicaltrials.eu/ctis-public/view/2022-502528-29-00